EU clinical trial 2024-514478-37-00: Randomized, crossover, two-period, comparative bioavailability study of two ibuprofen (arginate) formulations, administered as solutions in single oral dose of 400 mg to healthy subjects under fasting conditions.
Protocol code: FMLD- IOSOL-61
Sponsor: Farmalider S.A. (Pharmaceutical company). Phase: Human Pharmacology (Phase I)- Other. Countries: Spain (ended).
Therapeutic area(s): Not possible to specify
Gender: Female, Male. Age: 18-64 years. Enrolment: 24.
Status: Ended. Start date (EU): 2024-10-04. End date (EU): 2024-11-20. Decision date: 2024-09-30. Results received: No. Last updated: 2024-09-30.

Condition(s): Healthy volunteers

Source: https://euclinicaltrials.eu/ctis-public/view/2024-514478-37-00